EU clinical trial 2023-503355-98-00: A Phase 1/2a Study to Evaluate the Safety, Tolerability, Pharmacokinetics and Pharmacodynamics of Intrathecally Administered ION717 in Patients with Prion Disease
Protocol code: ION717-CS2
Sponsor: Ionis Pharmaceuticals Inc. (Pharmaceutical company). Phase: Phase I and Phase II (Integrated)- First administration to humans. Countries: Spain (ongoing, recruitment ended), Italy (ongoing, recruitment ended), Germany (ongoing, recruitment ended), France (ongoing, recruitment ended).
Therapeutic area(s): Diseases [C] - Nervous System Diseases [C10]
Gender: Female, Male. Age: 18-64 years, 65+ years. Enrolment: 8.
Status: Ongoing, recruitment ended. Start date (EU): 2024-01-24. Decision date: 2023-10-19. Results received: No. Last updated: 2026-04-17.
Decision dates by country: DE: 2023-10-20, FR: 2024-04-15, IT: 2023-10-19, ES: 2023-10-19

Condition(s): Prion diseases

Source: https://euclinicaltrials.eu/ctis-public/view/2023-503355-98-00